EU clinical trial 2024-513575-40-01: Glutamate infusion for prevention of Acute Kidney Injury in surgery for ischemic heart disease: (GLUTAMICS III = GLUTAmate for Metabolic Intervention in Coronary Surgery III)
Sponsor: Region Oestergoetland (Hospital/Clinic/Other health care facility). Phase: Therapeutic confirmatory (Phase III). Countries: Sweden (authorised, recruitment pending).
Therapeutic area(s): Diseases [C] - Cardiovascular Diseases [C14]
Gender: Female, Male. Age: 18-64 years, 65+ years. Enrolment: 380.
Status: Authorised, recruitment pending. Decision date: 2024-09-05. Results received: No. Last updated: 2026-06-04.

Condition(s): Acute kidney injury and heart failure after coronary artery bypass surgery in patients without diabetes
Product: SODIUM CHLORIDE, L-GLUTAMIC ACID, L-GLUTAMIC ACID

Primary endpoint: Incidence of postoperative acute kidney injury (AKI) measured as >= 50% postoperative increase of p-creatinine compared to preoperative value
Endpoint(s): Postoperative increase of p-NT-proBNP from the day before surgery to the third postoperative day, Plasma - neutrophil gelatinase–associated lipocalin (NGAL) on postoperative day 3, Estimated creatinine clearance (Cockcroft–Gault) at 6 months following surgery related to preoperative level

Source: https://euclinicaltrials.eu/ctis-public/view/2024-513575-40-01